EU clinical trial 2023-504586-24-00: A study to learn if UCB3101 is safe and how it moves through the body of healthy participants
Protocol code: UP0124
Sponsor: UCB Biopharma (Pharmaceutical company). Phase: Human Pharmacology (Phase I)- First administration to humans. Countries: Belgium (ended).
Therapeutic area(s): Diseases [C] - Nervous System Diseases [C10]
Gender: Female, Male. Age: 18-64 years, 65+ years. Enrolment: 88.
Status: Ended. Start date (EU): 2024-07-31. End date (EU): 2025-12-04. Decision date: 2024-06-14. Results received: No. Last updated: 2025-05-09.

Condition(s): Healthy Participants

Source: https://euclinicaltrials.eu/ctis-public/view/2023-504586-24-00